EU clinical trial 2024-513248-27-00: Multicentre, randomized, controlled, open-label, multi-centre medicoeconomic study evaluating the efficacy of adding zoledronic acid or denosumab to Stereotaxic radiotherapy in the treatment of vertebral metastases (ZOSTER)
Protocol code: ZOSTER ICO-N-2018-14
Sponsor: Institut De Cancerologie De L Ouest (Hospital/Clinic/Other health care facility). Phase: Therapeutic confirmatory (Phase III). Countries: France (ongoing, recruiting).
Therapeutic area(s): Diseases [C] - Neoplasms [C04]
Gender: Female, Male. Age: 18-64 years, 65+ years. Enrolment: 202.
Status: Ongoing, recruiting. Start date (EU): 2020-07-20. Decision date: 2024-06-17. Results received: No. Last updated: 2025-08-22.

Condition(s): Patients, men or women over 18 old, with inoperable vertebral bone metastases who must beneficit treatment with stereotactic radiotherapy
Product: Zometa 4 mg/100 ml solution for infusion, XGEVA 120 mg solution for injection in pre-filled syringe

Primary endpoint: of life gained in good health. Calculating the ICER requires : - Identifying care consumption; - Measuring costs; - Estimating overall survival; - Calculating utilities using the EQ5D-5L questionnaire (appendix 11). The ROCR will be measured at 6 months and 24 months after the start of radiotherapy.
Endpoint(s): Cost-effectiveness analysis: calculation of a Differential Cost Outcome Ratio (DCOER) expressed as a cost per life-year gained measured at 6 months and 24 months from the start of radiotherapy;, Budget impact analysis: estimation of the target and reached populations, calculation of the additional costs and avoided costs generated by the diffusion of the innovation in the French healthcare system., Survival without CVF (vertebral compression fractures) estimated at 6, 12 and 24 months., Survival without bone complications estimated at 6, 12 and 24 months, Acute and delayed toxicity: according to CTCAE 5 ;, Pain control: VAS and BPI (appendix 12) assessed at inclusion, 6, 12 and 24 months;, Local control of irradiated tumour lesions: MRI and TAP and/or PET scan (quarterly monitoring or in the event of neurological signs) assessed at 6 and 12 months;, Neoplastic Spinal Instability Score (NSSI) assessed at inclusion, 6 and 12 months, Assessment of bone density: bone densitometry at inclusion, 6 and 12 months;, Measurement of markers of immune response and bone remodelling;, Sensitivity and specificity of the algorithm for detecting the risk of fracture at 1 year.

Source: https://euclinicaltrials.eu/ctis-public/view/2024-513248-27-00